EU clinical trial 2023-504977-19-00: A Phase 3 Study of the Efficacy, Safety and Pharmacokinetics of Ustekinumab as Open-label Intravenous Induction Treatment Followed by Randomized Double-blind Subcutaneous Ustekinumab Maintenance in Pediatric Participants with Moderately to Severely Active Ulcerative Colitis
Protocol code: CNTO1275PUC3001
Sponsor: Janssen - Cilag International (Pharmaceutical company). Phase: Therapeutic confirmatory (Phase III). Countries: Germany (ended), Hungary (ended), Belgium (ended), Poland (ended).
Therapeutic area(s): Diseases [C] - Immune System Diseases [C20]
Gender: Female, Male. Age: 0-17 years. Enrolment: 49.
Status: Ended. Start date (EU): 2021-03-15. End date (EU): 2025-06-05. End date: 2025-06-06. Decision date: 2023-08-03. Results received: Yes. Last updated: 2025-04-14.
Decision dates by country: DE: 2023-08-14, BE: 2023-08-03, PL: 2023-09-18, HU: 2023-08-07

Condition(s): Moderately to Severely Active Ulcerative Colitis
Product: STELARA 90 mg solution for injection in pre-filled syringe, STELARA 130 mg concentrate for solution for infusion, Placebo 1, STELARA 45 mg solution for injection, Placebo 2

Primary endpoint: Clinical remission at Week I-8

Source: https://euclinicaltrials.eu/ctis-public/view/2023-504977-19-00